EU clinical trial 2024-510948-31-00: An open-label, multi-center, global, rollover study for patients who have previously been treated with capmatinib (INC280) as monotherapy or in combination in a Novartis Sponsored trial
Protocol code: CINC280A2X02B
Sponsor: Novartis Pharma AG (Pharmaceutical company). Phase: Therapeutic exploratory (Phase II). Countries: Belgium (ongoing, recruitment ended), Germany (ongoing, recruitment ended), Italy (ongoing, recruitment ended).
Therapeutic area(s): Diseases [C] - Neoplasms [C04]
Gender: Female, Male. Age: 18-64 years, 65+ years. Enrolment: 11.
Status: Ongoing, recruitment ended. Start date (EU): 2017-07-04. Decision date: 2024-06-12. Results received: No. Last updated: 2026-04-14.
Decision dates by country: DE: 2024-06-12, BE: 2024-06-12, IT: 2024-06-17

Condition(s): cMET-dependent malignancies
Product: EGF816, INC280, EGF816, GEFITINIB, INC280, EGF816

Primary endpoint: Safety: Frequency and severity of AEs/SAEs

Source: https://euclinicaltrials.eu/ctis-public/view/2024-510948-31-00